EU clinical trial 2024-516781-10-00: An open label, phase 1 study to evaluate the safety, feasibility and immunogenicity of an allogeneic, cell-based vaccine (VIDIDENCEL) in high grade serous ovarian cancer patients after primary treatment (ALISON)
Sponsor: Universitair Medisch Centrum Groningen (Hospital/Clinic/Other health care facility). Phase: Human Pharmacology (Phase I)- First administration to humans. Countries: Netherlands (ended).
Therapeutic area(s): Diseases [C] - Neoplasms [C04]
Gender: Female. Age: 18-64 years, 65+ years. Enrolment: 17.
Status: Ended. Start date (EU): 2024-09-16. End date (EU): 2025-12-23. Decision date: 2024-09-16. Results received: No. Last updated: 2024-11-19.

Condition(s): High grade serous ovarian cancer

Source: https://euclinicaltrials.eu/ctis-public/view/2024-516781-10-00